EU clinical trial 2025-522015-42-00: A Phase 2b/3, Open-Label, Multicenter Trial Evaluating the Efficacy and Safety of Switching to Brelovitug for the Treatment of Chronic Hepatitis Delta Infection in Participants Receiving Bulevirtide (AZURE-3)
Protocol code: BJT-778-303
Sponsor: Mirum Pharmaceuticals Inc. (Pharmaceutical company). Phase: Phase II and Phase III (Integrated). Countries: Czechia (ongoing, recruiting), Austria (ongoing, recruiting), Spain (ongoing, recruiting), Romania (ongoing, recruiting), Germany (ongoing, recruiting), Italy (ongoing, recruiting), France (ongoing, recruiting).
Therapeutic area(s): Diseases [C] - Virus Diseases [C02]
Gender: Female, Male. Age: 18-64 years, 65+ years. Enrolment: 115.
Status: Ongoing, recruiting. Start date (EU): 2026-02-26. Decision date: 2026-02-03. Results received: No. Last updated: 2026-07-30.
Decision dates by country: IT: 2026-02-05, RO: 2026-02-09, ES: 2026-02-09, DE: 2026-02-06, AT: 2026-02-07, CZ: 2026-02-04, FR: 2026-02-03

Condition(s): Chronic Hepatitis D Infection
Product: BULEVIRTIDE, BJT-778

Primary endpoint: The proportion of participants who achieve: • Undetectable HDV RNA (< LLOQ, target not detected [TND])
Endpoint(s): Safety endpoints will evaluate: • Incidence and severity of treatment-emergent adverse events (TEAE) • Proportion of participants who permanently discontinue treatment due to an adverse event • Change from baseline of serum total bile salts Comparison with bulevirtide will include data through 24 weeks., The proportion of participants who achieve the following at Weeks 24, 48, 72, and 96 of treatment unless otherwise specified: • Virologic response defined as HDV RNA ≥2 log10 IU/mL decline from baseline or HDV RNA < LLOQ, TND • HDV RNA < LLOQ • HDV RNA < LLOQ, TND (Weeks 48, 72, and 96), • Normal ALT alone and in combination with: − Virologic response defined as HDV RNA ≥ 2 log10 IU/mL decline from baseline or HDV RNA < LLOQ, TND − HDV RNA < LLOQ − HDV RNA < LLOQ, TND • Change from baseline of HDV RNA • Change from baseline of ALT Comparison with bulevirtide will include data through 24 weeks, • Proportion of participants who achieve HDV RNA < LLOQ, TND at post-treatment follow-up Weeks 24 and 48

Source: https://euclinicaltrials.eu/ctis-public/view/2025-522015-42-00